EU clinical trial 2023-504536-18-00: Immune-modulatory radiotherapy to enhance the effects of neoadjuvant PD-L1 blockade after neoadjuvant chemotherapy in patients with resectable stage III(N2) non-small cell lung cancer (NSCLC). A multicenter phase II trial.
Protocol code: SAKK 16/18
Sponsor: Swiss Group for Clinical Cancer Research (Pharmaceutical company). Phase: Therapeutic exploratory (Phase II). Countries: Germany (ongoing, recruitment ended).
Therapeutic area(s): Diseases [C] - Respiratory Tract Diseases [C08]
Gender: Female, Male. Age: 18-64 years, 65+ years. Enrolment: 10.
Status: Ongoing, recruitment ended. Start date (EU): 2024-07-31. Decision date: 2024-04-17. Results received: No. Last updated: 2025-10-22.

Condition(s): Resectable, locally advanced non-small cell lung cancer (NSCLC, N2)
Product: Carboplat onkovis 10 mg/ml Konzentrat zur Herstellung einer Infusionslösung, Paclitaxel onkovis, 6 mg/ml, Konzentrat zur Herstellung einer Infusionslösung, Doce onkovis 20 mg/ ml Konzentrat zur Herstellung einer Infusionslösung, IMFINZI 50 mg/mL concentrate for solution for infusion., Pemetrexed medac 500 mg Pulver für ein Konzentrat zur Herstellung einer Infusionslösung, Vinorelbin onkovis 10 mg/ml Konzentrat zur Herstellung einer Infusionslösung, Pemetrexed medac 100 mg Pulver für ein Konzentrat zur Herstellung einer Infusionslösung, Cisplatin Teva® 1 mg/ml Konzentrat zur Herstellung einer Infusionslösung

Primary endpoint: Event-free survival (EFS) at 12 months
Endpoint(s): Event-free survival (EFS), Recurrence-free survival (RFS) after R0 resection, Overall survival (OS), Objective response (OR) after neoadjuvant chemotherapy, OR after neoadjuvant immunotherapy and immune-modulatory radiotherapy, Pathological complete response (pCR), Local major pathological response (MPR), Overall major pathological response (oMPR), Rate of nodal down-staging to < ypN2, Complete resection rate, Pattern of recurrence (loco-regional, distant), Adverse events (AEs) and surgical complications, Delay in surgery, Postoperative 30-day mortality

Source: https://euclinicaltrials.eu/ctis-public/view/2023-504536-18-00